EU clinical trial 2024-512351-21-00: Study of the compound RCS-21 on the safety of healthy volunteers, its tolerability and on the way the body absorbs, distributes, and gets rid of this drug.
Protocol code: RNATICS-2401
Sponsor: Rnatics GmbH (Industry). Phase: Human Pharmacology (Phase I)- First administration to humans. Countries: Germany (ongoing, recruiting).
Therapeutic area(s): Diseases [C] - Respiratory Tract Diseases [C08]
Gender: Female, Male. Age: 18-64 years. Enrolment: 24.
Status: Ongoing, recruiting. Start date (EU): 2024-12-10. Decision date: 2024-11-08. Results received: No. Last updated: 2026-05-04.

Condition(s): Safety, tolerability and pharmacokinetics of single-ascending doses of RCS-21 in healthy volunteers (AMIR-21)

Source: https://euclinicaltrials.eu/ctis-public/view/2024-512351-21-00